EU clinical trial 2024-511823-32-00: A Phase 2 Open label (Core Phase Plus Extension Phase) With 2 Cohorts Study to Assess the Pharmacokinetics and Safety of Givinostat in DMD Patients Ages From at Least 2 Years to Less Than 6 Years Old
Protocol code: DSC/14/2357/52
Sponsor: Italfarmaco S.p.A. (Pharmaceutical company). Phase: Therapeutic exploratory (Phase II). Countries: Netherlands (ongoing, recruiting), Italy (ongoing, recruiting), Belgium (ongoing, recruiting).
Therapeutic area(s): Diseases [C] - Musculoskeletal Diseases [C05]
Gender: Male. Age: 0-17 years. Enrolment: 10.
Status: Ongoing, recruiting. Start date (EU): 2024-11-06. Decision date: 2024-10-07. Results received: No. Last updated: 2025-03-21.
Decision dates by country: BE: 2024-10-07, NL: 2024-10-11, IT: 2024-11-21

Condition(s): Duchenne muscular dystrophy (DMD)
Product: ITF2357

Primary endpoint: CORE PHASE: Area under the concentration-time curve from dosing (time 0) to time t at steady state (AUC0-T,ss) after at least 7 days of dosing (at Week 1 and at 6 months) CORE PHASE: Maximum plasma concentration at steady state (Cmax,ss) after at least 7 days of dosing (at Week 1 and at 6 months) CORE PHASE: Elimination half life (t1/2) assessed after at least 7 days of dosing dosing (at Week 1 and at 6 months), EXTENSION PHASE: • Type, incidence, and severity of TEAEs and SAEs from baseline up to Week 144 • Proportion of subjects experiencing TEAEs from baseline to Week 144
Endpoint(s): CORE PHASE: • Type, incidence, and severity of treatment-emergent adverse events (TEAEs) and SAEs from baseline to Week 48 • Proportion of subjects experiencing TEAEs from baseline to Week 48 • Change from baseline vital signs and clinical laboratory tests to each postbaseline visit up to Week 48 • Change from baseline electrocardiogram (ECG) to each postbaseline visit up to Week 48, CORE PHASE: • Change in physical function as per the Bayley III Gross Motor scale from baseline to Week 48 for subjects aged ≥2 to <3.5 years of age • Change in physical function as per the North Star Ambulatory Assessment (NSAA) total score from baseline to Week 48 for subjects aged ≥3.5 years of age, CORE PHASE: • Change in Paediatric Outcomes Data Collection Instrument (PODCI) from baseline to Week 48 for subjects aged ≥4 years of age in Cohort 1 only, EXTENSION PHASE: • Type, incidence, and severity of TEAEs and SAEs from baseline up to Week 144 • Proportion of patients experiencing TEAEs from baseline to Week 144 • Change from baseline vital signs and clinical laboratory tests to each postbaseline visit up to Week 144 • Change from baseline ECG to each postbaseline up to Week 144

Source: https://euclinicaltrials.eu/ctis-public/view/2024-511823-32-00